EU clinical trial 2023-509233-39-00: A Phase 2, Multicenter, Randomized, Double-Blind, Placebo Controlled, Parallel Group Study to Evaluate the Clinical Efficacy and Safety of VTX002 in Subjects with Moderately to Severely Active Ulcerative Colitis
Protocol code: VTX002-201
Sponsor: Oppilan Pharma Limited (Pharmaceutical company). Phase: Therapeutic exploratory (Phase II). Countries: Germany (ended), Czechia (ended), Slovakia (ended), Hungary (ended), Bulgaria (ended), Poland (ended), Lithuania (ended), Italy (ended).
Therapeutic area(s): Diseases [C] - Digestive System Diseases [C06]
Gender: Female, Male. Age: 18-64 years, 65+ years. Enrolment: 132.
Status: Ended. Start date (EU): 2022-01-20. End date (EU): 2025-02-27. End date: 2025-02-28. Decision date: 2024-09-20. Results received: Yes. Last updated: 2025-04-22.
Decision dates by country: BG: 2024-09-25, CZ: 2024-09-20, DE: 2024-09-24, HU: 2024-09-20, IT: 2024-10-14, LT: 2024-10-23, SK: 2024-09-20, PL: 2024-10-07

Condition(s): Moderately to Severely Active Ulcerative Colitis
Product: tamuzimod, tamuzimod, tamuzimod, VTX002 placebo film-coated tablets matching VTX002, tamuzimod

Primary endpoint: The proportion of participants with clinical remission at Week 13 using modified Mayo score (MMS)
Endpoint(s): The proportion of participants with endoscopic improvement at Week 13, The proportion of participants with symptomatic remission at Week 13, The proportion of participants with histologic remission at Week 13, The proportion of participants with endoscopic improvement-histologic remission at Week 13

Source: https://euclinicaltrials.eu/ctis-public/view/2023-509233-39-00